EU clinical trial 2023-504506-11-00: Phase 1/2 Study of mRNA-4359 Administered Alone and in Combination With Immune Checkpoint Blockade in Participants with Advanced Solid Tumors
Protocol code: mRNA-4359-P101
Sponsor: Moderna Inc. (Pharmaceutical company). Phase: Phase I and Phase II (Integrated)- First administration to humans. Countries: Spain (ongoing, recruitment ended), Poland (ongoing, recruiting), Italy (authorised, recruiting), Germany (ongoing, recruitment ended).
Therapeutic area(s): Diseases [C] - Neoplasms [C04]
Gender: Female, Male. Age: 0-17 years, 18-64 years, 65+ years. Enrolment: 45.
Start date (EU): 2026-08-04. Decision date: 2023-07-26. Results received: No. Last updated: 2026-06-09.
Decision dates by country: DE: 2026-06-05, IT: 2025-09-01, ES: 2023-07-26, PL: 2023-07-28

Condition(s): Advanced Solid Tumors
Product: mRNA-4359, OPDIVO 10 mg/mL concentrate for solution for infusion., SODIUM CHLORIDE, PEMBROLIZUMAB, YERVOY 5 mg/ml concentrate for solution for infusion

Primary endpoint: For Arm 1, 2a, 2b, 2c: Define the MTD and/or RDE of mRNA-4359 (Arm 1a and Arm 1b only), the incidence, nature, and severity of DLTs and AEs, AESIs, and SAEs, including, but not limited to, changes in laboratory results, vital signs, and physical examination after the administration of mRNA-4359 alone and in combination with pembrolizumab or ipilimumab and nivolumab. For Arm 2d: ORR based on BICR per RECIST v1.1 criteria.
Endpoint(s): For Arm 1, 2a, 2b, 2c: ORR, DCR, DoR, and PFS based on Investigator Assessment per RECIST v1.1 criteria. For Arm 2d: DoR, DCR, and PFS based on BICR per RECIST v1.1 criteria, and OS based on Investigator assessment., For Arm 1, 2a, 2b, 2c: Change (or % change) from baseline in T cell profile in the tumor., For Arm 2d: The incidence, nature, and severity of AEs, AESIs, and SAEs, after the administration of mRNA-4359 in combination with pembrolizumab., For Arm 2d: Change from baseline in health-related quality of life as measured by FACT-M.

Source: https://euclinicaltrials.eu/ctis-public/view/2023-504506-11-00